EU clinical trial 2024-515650-24-00: Clinical Trial Using Humanized CART Directed Against BCMA (ARI0002h) in Patients With Relapsed/Refractory Multiple Myeloma to Proteasome Inhibitors, Immunomodulators and Anti-CD38 Antibody
Protocol code: CARTBCMA-HCB-01
Sponsor: Fundacio De Recerca Clinic Barcelona-Institut D’Investigacions Biomediques August Pi I Sunyer (Laboratory/Research/Testing facility). Phase: Therapeutic exploratory (Phase II). Countries: Spain (ended).
Therapeutic area(s): Diseases [C] - Neoplasms [C04]
Gender: Female, Male. Age: 18-64 years, 65+ years. Enrolment: 30.
Status: Ended. Start date (EU): 2024-07-26. End date (EU): 2025-11-07. Decision date: 2024-07-26. Results received: No. Last updated: 2024-07-26.

Condition(s): Multiple Myeloma

Source: https://euclinicaltrials.eu/ctis-public/view/2024-515650-24-00